EU clinical trial 2024-518609-17-00: The effect of CBD on sleep quality following late evening exercise
Sponsor: UZ Leuven (Hospital/Clinic/Other health care facility). Phase: Therapeutic exploratory (Phase II). Countries: Belgium (ongoing, recruiting).
Therapeutic area(s): Phenomena and Processes [G] - Physiological processes [G07]
Gender: Female, Male. Age: 18-64 years. Enrolment: 20.
Status: Ongoing, recruiting. Start date (EU): 2026-03-19. Decision date: 2026-01-21. Results received: No. Last updated: 2026-05-29.

Condition(s): healthy individuals
Product: Softisan 378, Cannabidiol

Primary endpoint: Changes in sleep efficiency between different sessions
Endpoint(s): Changes in other sleep indices between different sessions, Changes in perceived sleep quality between different sessions, Changes in circulating hormones involved in sleep and stress between different sessions, Changes in plasma catecholamines and serotonin between different sessions, Changes urinary catecholamine and serotonin excretion between different sessions

Source: https://euclinicaltrials.eu/ctis-public/view/2024-518609-17-00